EU clinical trial 2024-515813-17-00: Randomized, double-blind, placebo-controlled clinical trial to evaluate the efficacy of intravenous metoprolol in patients with Acute Respiratory Distress Syndrome (ARDS).
Sponsor: Consorcio Centro De Investigacion Biomedica En Red (Laboratory/Research/Testing facility). Phase: Therapeutic confirmatory (Phase III). Countries: Spain (ended).
Therapeutic area(s): Diseases [C] - Respiratory Tract Diseases [C08]
Gender: Female, Male. Age: 18-64 years, 65+ years. Enrolment: 350.
Status: Ended. End date (EU): 2025-10-03. Decision date: 2024-11-14. Results received: Yes. Last updated: 2025-02-17.
Decision dates by country: ES: 2025-01-13

Condition(s): Acute Respiratory Distress Syndrome (ARDS)
Product: Beloken 1 mg/ml solución inyectable

Primary endpoint: Days alive and free of invasive mechanical ventilation during the first 28 days. [ Time Frame: 28 days ] Hierarchical composite outcome "Alive and ventilator-free days at 28 days" (win ratio approach)
Endpoint(s): All-cause death at day 28 after randomization [ Time Frame: 28 days ] cumulative incidence of death from any cause, Ventilator-free days at 28 days [ Time Frame: 28 days ] number of days without mechanical ventilation during the firs 28 days, Intensive care unit days of admission [ Time Frame: 3 months ] Number of days admitted at the intensive care unit, Quality of life score [ Time Frame: at 3 months ] Mean quality of life score according to ''The Short Form 36 Health Survey Questionnaire'' (SF-36). The SF-36 is a 36 item scale, which measures eight domains of health status: physical functioning (10 items); physical role limitations (four items); bodily pain (two items); general health perceptions (five items); energy/vitality (four items); social functioning (two items); emotional role limitations (three items) and mental health (five ítems)., Arterial oxygenation [ Time Frame: on day 8 ] Mean arterial oxygen saturation (PaO2/FiO2), Change in arterial oxygenation [ Time Frame: 8 days ] Mean difference in arterial oxygen saturation (PaO2/FiO2) between baseline and day 8

Source: https://euclinicaltrials.eu/ctis-public/view/2024-515813-17-00